EU clinical trial 2022-502183-20-00: I6T-MC-AMBA - A Multicenter, Phase 3, Open-Label Study to Investigate the Efficacy, Pharmacokinetics, and Safety of Mirikizumab in Participants 2 Years to Less Than 18 Years of Age with Moderately to Severely Active Ulcerative Colitis
Protocol code: I6T-MC-AMBA
Sponsor: Eli Lilly & Co. (Pharmaceutical company). Phase: Therapeutic confirmatory (Phase III). Countries: Belgium (ended), Portugal (ended), Poland (ended), Italy (ended), Netherlands (ended), Germany (ended), France (ended).
Therapeutic area(s): Diseases [C] - Digestive System Diseases [C06]
Gender: Female, Male. Age: 0-17 years. Enrolment: 30.
Status: Ended. Start date (EU): 2024-02-26. End date (EU): 2026-04-24. End date: 2026-05-01. Decision date: 2024-01-12. Results received: No. Last updated: 2025-11-27.
Decision dates by country: PT: 2024-01-12, BE: 2024-01-15, FR: 2024-01-16, PL: 2024-01-12, IT: 2024-01-12, NL: 2024-01-15, DE: 2024-01-15

Condition(s): Moderately to Severely Active Ulcerative Colitis
Product: Omvoh 300 mg concentrate for solution for infusion, Omvoh 100 mg solution for injection in pre-filled syringe

Primary endpoint: Percentage of Participants with Modified Mayo Score (MMS) Clinical Remission at Week 52 among the Week 12 Clinical Responders

Source: https://euclinicaltrials.eu/ctis-public/view/2022-502183-20-00